EU clinical trial 2023-505967-36-00: A Translational Phase 1B, 2-Part Study to Evaluate Pharmacokinetics, Safety and Pharmacodynamics of Treatment with ATX-304 Na Salt Tablets.
Sponsor: Betagenon AB (Pharmaceutical company). Phase: Human Pharmacology (Phase I)- Other. Countries: Netherlands (ended), Germany (ended).
Therapeutic area(s): Diseases [C] - Cardiovascular Diseases [C14]
Gender: Female, Male. Age: 18-64 years, 65+ years. Enrolment: 72.
Status: Ended. Start date (EU): 2023-09-15. End date (EU): 2025-05-07. Decision date: 2023-09-15. Results received: No. Last updated: 2024-10-16.
Decision dates by country: NL: 2023-09-15, DE: 2024-03-19

Condition(s): Obesity with prediabetes or type 2 diabetes mellitus

Source: https://euclinicaltrials.eu/ctis-public/view/2023-505967-36-00